EU clinical trial 2025-521107-42-00: A Multi-Center, Single Arm, Open-Label Extension Study to Evaluate the Long-term Safety and Efficacy of GSK4527226 [AL101] in Participants with Early Alzheimer’s Disease.
Protocol code: 223646
Sponsor: Glaxosmithkline Research & Development Limited (Pharmaceutical company). Phase: Therapeutic exploratory (Phase II). Countries: Sweden (ended), Norway (ended), Italy (ended), France (ended), Spain (ended), Finland (ended), Netherlands (ended), Germany (ended).
Therapeutic area(s): Diseases [C] - Nervous System Diseases [C10]
Gender: Female, Male. Age: 18-64 years, 65+ years. Enrolment: 143.
Status: Ended. Start date (EU): 2025-11-25. End date (EU): 2026-04-29. Decision date: 2025-10-23. Results received: No. Last updated: 2026-04-14.
Decision dates by country: FI: 2025-10-23, FR: 2025-10-24, DE: 2025-10-24, ES: 2025-10-27, SE: 2025-10-24, NO: 2025-10-23, NL: 2025-11-10, IT: 2025-10-27

Condition(s): Alzheimer's Disease

Primary endpoint: Incidence of treatment emergent AEs, including AESIs and SAEs, during the OLE, Incidence and severity of ARIAs during the OLE
Endpoint(s): Change from OLE baseline1 during the OLE in cognitive assessments: • CDR-SB • ADAS-Cog14 • MMSE • ADCS-ADL-MCI • iADRS • ADCOMS

Source: https://euclinicaltrials.eu/ctis-public/view/2025-521107-42-00